EU clinical trial 2022-503068-34-00: ATEZOGIST – A prospective, randomized, multicenter, comparative study of the efficacy of imatinib resumption combined with atezolizumab versus imatinib resumption alone in patients with unresectable advanced gastrointestinal stromal tumors (GIST) after failure of standard treatments
Protocol code: ET19-075
Sponsor: Centre Leon Berard (Hospital/Clinic/Other health care facility). Phase: Therapeutic exploratory (Phase II). Countries: France (ongoing, recruiting).
Therapeutic area(s): Diseases [C] - Neoplasms [C04]; Diseases [C] - Skin and Connective Tissue Diseases [C17]
Gender: Female, Male. Age: 18-64 years, 65+ years. Enrolment: 110.
Status: Ongoing, recruiting. Start date (EU): 2022-04-06. Decision date: 2024-01-15. Results received: No. Last updated: 2026-03-16.

Condition(s): Metastatic Gastrointestinal Stromal Tumor, Unresectable Gastrointestinal Stromal Tumor (GIST), Locally Advanced Gastrointestinal Stromal Tumor (GIST)
Product: IMATINIB, Tecentriq 1 200 mg concentrate for solution for infusion

Primary endpoint: Progression-Free Survival
Endpoint(s): 1.Best Response Rate, 2.Objective Response Rate, 3.Time to Treatment Failure, 4.Overall Survival, 5.Quality of Life 6.Tolerability profile

Source: https://euclinicaltrials.eu/ctis-public/view/2022-503068-34-00